EU clinical trial 2022-502414-84-00: A study to test a medicine (fitusiran) for preventing bleeds in people with severe hemophilia who previously received preventive treatment with emicizumab
Protocol code: SFY17741
Sponsor: Sanofi-Aventis Research & Development (Pharmaceutical company). Phase: Human Pharmacology (Phase I)- Other. Countries: Italy (ended), Spain (ended).
Therapeutic area(s): Diseases [C] - Hemic and Lymphatic Diseases [C15]
Gender: Male. Age: 18-64 years, 65+ years. Enrolment: 6.
Status: Ended. End date (EU): 2024-09-24. Decision date: 2024-02-05. Results received: No. Last updated: 2024-02-06.
Decision dates by country: IT: 2024-02-06, ES: 2024-02-05

Condition(s): Hemophilia A

Source: https://euclinicaltrials.eu/ctis-public/view/2022-502414-84-00